EU clinical trial 2023-506724-85-00: H8H-MC-LAHW: A Phase 3, 12-Month, Open-Label Study of Lasmiditan in Pediatric Patients with Migraine - PIONEER-PEDS2
Protocol code: H8H-MC-LAHW
Sponsor: Eli Lilly & Co. (Pharmaceutical company). Phase: Therapeutic confirmatory (Phase III). Countries: France (ended), Germany (ended), Spain (ended), Italy (ended), Belgium (ended), Netherlands (ended), Romania (ended).
Therapeutic area(s): Diseases [C] - Nervous System Diseases [C10]
Gender: Female, Male. Age: 0-17 years. Enrolment: 175.
Status: Ended. Start date (EU): 2020-11-19. End date (EU): 2025-12-04. End date: 2025-12-05. Decision date: 2023-09-07. Results received: Yes. Last updated: 2026-06-17.
Decision dates by country: RO: 2023-09-29, ES: 2023-09-11, FR: 2023-09-11, DE: 2023-09-11, IT: 2023-09-11, NL: 2023-10-03, BE: 2023-09-07

Condition(s): Migraine
Product: Lasmitidan, LASMIDITAN, Lasmiditan, Lasmiditan, LASMIDITAN

Primary endpoint: Percentage of Treatment Emergent Adverse Events (TEAEs) by Treated Migraine Attack, Percentage of Participants with Discontinuations Due to Adverse Events (AEs)

Source: https://euclinicaltrials.eu/ctis-public/view/2023-506724-85-00